EU clinical trial 2025-523935-20-00: A Randomized, Double-blind, Parallel-group Phase III Study to Evaluate the Efficacy, Safety, and Tolerability of Elecoglipron Compared with Placebo in Adults with Type 2 Diabetes Mellitus on Background Insulin (Eluminate-3)
Protocol code: D7261C00006
Sponsor: AstraZeneca AB (Pharmaceutical company). Phase: Therapeutic confirmatory (Phase III). Countries: Germany (authorised, recruitment pending), Bulgaria (authorised, recruitment pending), Czechia (authorised, recruitment pending).
Therapeutic area(s): Diseases [C] - Nutritional and Metabolic Diseases [C18]
Gender: Female, Male. Age: 18-64 years, 65+ years. Enrolment: 160.
Status: Authorised, recruitment pending. Decision date: 2026-08-04. Results received: No. Last updated: 2026-08-07.
Decision dates by country: BG: 2026-08-07, CZ: 2026-08-04, DE: 2026-08-04

Condition(s): type 2 diabetes mellitus
Product: Elecoglipron, Placebo for Elecoglipron (AZD5004), Elecoglipron, Elecoglipron, Elecoglipron

Primary endpoint: Change from baseline to Week 40 in HbA1c (%)
Endpoint(s): Achieved HbA1c < 7% (53 mmol/mol) at Week 40, Achieved HbA1c ≤ 6.5% (48 mmol/mol) at Week 40, Percent change from baseline to Week 40 in body weight, Change from baseline to Week 40 in body weight (kg), Change from baseline to Week 40 in SBP

Source: https://euclinicaltrials.eu/ctis-public/view/2025-523935-20-00